EU clinical trial 2023-508224-35-01: Analgesic effect of intravenous lidocaïne and its mechanisms in patients suffering from chronic inflammatory bowel disease (IBD) with abdominal pain.
Sponsor: CHU De Liege (Hospital/Clinic/Other health care facility). Phase: Therapeutic exploratory (Phase II). Countries: Belgium (ongoing, recruiting).
Therapeutic area(s): Diseases [C] - Digestive System Diseases [C06]
Gender: Female, Male. Age: 18-64 years, 65+ years. Enrolment: 80.
Status: Ongoing, recruiting. Start date (EU): 2024-09-30. Decision date: 2024-07-17. Results received: No. Last updated: 2026-03-06.

Condition(s): Inflammatory Bowel disease
Product: Linisol 1 %, solution injectable, NaCl 0,9 % B. Braun, solution pour perfusion

Primary endpoint: We hope to be able to reduce the background pain scores and decrease the frequency of hyperalgesia flare-ups, and thus reduce the psychosocial impacts associated in these patients.

Source: https://euclinicaltrials.eu/ctis-public/view/2023-508224-35-01